EU clinical trial 2025-523479-49-00: A Phase 2a Randomized, Double-Blind, Placebo-Controlled Study to Evaluate the Efficacy and Safety of MK-8690 in Adult Participants with Moderately to Severely Active Ulcerative Colitis
Protocol code: MK-8690-002
Sponsor: Merck Sharp & Dohme LLC (Pharmaceutical company). Phase: Therapeutic exploratory (Phase II). Countries: Italy (authorised, recruitment pending), Greece (ongoing, recruiting), Netherlands (authorised, recruiting), Poland (ongoing, recruiting), Germany (authorised, recruitment pending), France (authorised, recruiting).
Therapeutic area(s): Diseases [C] - Digestive System Diseases [C06]
Gender: Female, Male. Age: 18-64 years, 65+ years. Enrolment: 44.
Start date (EU): 2026-06-29. Decision date: 2026-06-22. Results received: No. Last updated: 2026-06-29.
Decision dates by country: FR: 2026-06-22, DE: 2026-06-23, GR: 2026-06-23, IT: 2026-06-24, PL: 2026-06-29, NL: 2026-06-29

Condition(s): Colitis ulcerative
Product: MK-8690, Placebo for MK-8690

Primary endpoint: Percentage of Participants Achieving Clinical Remission Per Modified Mayo Score (MMS) at Week 12
Endpoint(s): Percentage of Participants With One or More Adverse Events (AEs), Percentage of Participants Who Discontinued Study Intervention Due to an AE, Percentage of Participants Achieving Clinical Response Per MMS at Week 12, Percentage of Participants With Endoscopic Improvement at Week 12, Percentage of Participants Achieving Clinical Remission Per Partial Modified Mayo Score (pMMS) at Week 12, Percentage of Participants Achieving Histologic-Endoscopic Mucosal Improvement at Week 12

Source: https://euclinicaltrials.eu/ctis-public/view/2025-523479-49-00